EU clinical trial 2025-523230-77-00: A Phase 2 study of intratumoral administration of L19IL2/L19TNF in locally advanced Basal Cell Carcinoma patients progressed on or intolerant to systemic treatment.
Sponsor: Philogen S.p.A. (Pharmaceutical company). Phase: Therapeutic exploratory (Phase II). Countries: Germany (ongoing, recruiting), Italy (authorised, recruiting), Greece (authorised, recruitment pending), Spain (authorised, recruiting).
Therapeutic area(s): Diseases [C] - Neoplasms [C04]
Gender: Female, Male. Age: 18-64 years, 65+ years. Enrolment: 53.
Start date (EU): 2026-04-27. Decision date: 2026-02-10. Results received: No. Last updated: 2026-08-07.
Decision dates by country: GR: 2026-02-11, DE: 2026-02-10, ES: 2026-02-12, IT: 2026-02-10

Condition(s): Patients with locally advanced Basal Cell Carcinoma (LaBCC) amenable to intratumoral injection, who have progressed or intolerant to systemic treatment.
Product: Darleukin, Fibromun

Primary endpoint: Best Overall Response Rate (BORR) as defined by the BCC-RECIST-like criteria according to an Independent Central Review (ICR).

Source: https://euclinicaltrials.eu/ctis-public/view/2025-523230-77-00